EU clinical trial 2025-522127-95-00: NEOREM/NEO-1 - NEOREM : Neo-adjuvant Adaptive Master Trial for Localized Cancers with Rapid Evaluation of Molecular & Immune Status for Stratified Immunotherapies in Oncology / NEO-1 : Neo-adjuvant intratumoral Anti-CTLA4 + Anti-PD1 treatment in patients with localized melanoma
Protocol code: UC-IMM-2509/2510
Sponsor: Unicancer (Hospital/Clinic/Other health care facility). Phase: Therapeutic exploratory (Phase II). Countries: France (ongoing, recruiting).
Therapeutic area(s): Diseases [C] - Neoplasms [C04]
Gender: Female, Male. Age: 18-64 years, 65+ years. Enrolment: 50.
Status: Ongoing, recruiting. Start date (EU): 2026-01-12. Decision date: 2025-10-28. Results received: No. Last updated: 2026-06-22.

Condition(s): NEOREM: Localized solid malignancies that are eligible to receive neo-adjuvant therapy and have medical unmet needs related to disease-free survival, overall survival or quality of life / NEO-1: Resectable stage III cutaneous or mucosal melanoma amenable to intratumoral neo-adjuvant immunotherapy.
Product: YERVOY 5 mg/ml concentrate for solution for infusion, OPDIVO 10 mg/mL concentrate for solution for infusion.

Primary endpoint: NEO-1_The primary efficacy endpoint is defined as a pathological complete response (pCR) rate defined as the percentage of patients with pCR defined as the complete absence of viable tumor cells, or the major pathologic response (MPR) defined as less than 10% of surviving tumor cells in tumor biopsy of the surgical specimen., NEO-1_The primary safety endpoint defined as the percentage of patients whose surgery was delayed by more than 4 weeks beyond the planned timeline, due to treatment-related adverse events.
Endpoint(s): NEO-1_Objective Response Rate (ORR), defined as the proportion of patients achieving complete response (CR) or partial response (PR) as assessed by the investigator according to RECIST v1.1., NEO-1_Durable Clinical Benefit (DCB), defined as patient alive and without disease progression (complete response [CR] + partial response [PR] + stable disease [SD]) according to RECIST v1.1 at 6 weeks., NEO-1_Overall Survival (OS), defined as the time from inclusion until death from any cause. Patients who are alive at last follow-up news will be censored at this date., NEO-1_Recurrence-free survival (RFS), defined as the length of time from surgery until evidence of cancer recurrence or death of any cause, whichever occurs first., NEO-1_Distant metastasis-free survival (MFS), defined as the length of time from inclusion until evidence of distant metastases or death of any cause, whichever occurs first., NEO-1_Safety will be evaluated according to the incidence of adverse events (AEs) graded by the National Cancer Institute - common terminology criteria for adverse events NCI-CTCAE v6.0 and and the PRO-CTCAE. The PRO-CTCAE questionnaire will be used to evaluate the safety profile at inclusion, then weekly during the first three months starting from C1D1, and monthly throughout the first year of follow-up., NEO-1_Health-related quality of life will be evaluated through the EORTC QLQ-C30 questionnaire by collecting data at baseline and at each investigational medical product (IMP) administration cycle during the neo-adjuvant treatment period, at surgery and during the first year of the follow-up period (M1, M3, M6, M12).

Source: https://euclinicaltrials.eu/ctis-public/view/2025-522127-95-00